EU clinical trial 2024-518385-26-01: Justification AnD evaluation, in pOlymyalgia RhEumatica, of BARIcitinib versus placebo (JADORE-BARI study)
Protocol code: 29BRC23.0160
Sponsor: Centre Hospitalier Regional Et Universitaire De Brest (Hospital/Clinic/Other health care facility). Phase: Therapeutic confirmatory (Phase III). Countries: France (ongoing, recruiting).
Therapeutic area(s): Diseases [C] - Immune System Diseases [C20]
Gender: Female, Male. Age: 18-64 years, 65+ years. Enrolment: 140.
Status: Ongoing, recruiting. Start date (EU): 2025-12-18. Decision date: 2025-10-07. Results received: No. Last updated: 2026-06-19.

Condition(s): Polymyalgia Rheumatica (PMR)
Product: tablets containing placebo to match 4 mg baricitinib, tablets containing placebo to match 2 mg baricitinib, Olumiant 4 mg film-coated tablets, Olumiant 2 mg film-coated tablets

Primary endpoint: The primary outcome is a PMR-AS (CRP) ≤10 (no flare) without steroids at week 24.
Endpoint(s): PMR-AS (CRP) ≤10 (no flare) without steroids at week 24, PMR-AS (CRP) ≤10 (no flare) without steroids at week 12, PMR-AS (CRP) ≤10 (no flare) without steroids at week 12, PMR-AS (CRP) ≤10 (no flare) without steroids at week 24, PMR-AS (CRP) ≤10 (no flare) without steroids at week 12, Exploratory End Points (see synopsis), PMR-AS (CRP) ≤10 (no flare) without steroids at week 36, PMR-AS (CRP) ≤10 (no flare) without steroids at week 36, PMR-AS (CRP) ≤10 (no flare) without steroids at week 36

Source: https://euclinicaltrials.eu/ctis-public/view/2024-518385-26-01